EU clinical trial 2025-523570-17-00: A randomized, Phase 2a, double-blinded, biomarker-driven, placebo-controlled study to assess safety, CNS penetration, and target engagement of Mirivadelgat in Parkinson’s disease – SLEIPNIR-2, a sub-protocol in the SLEIPNIR platform trial
Protocol code: SLEIPNIR-2
Sponsor: Helse Bergen HF (Hospital/Clinic/Other health care facility). Phase: Therapeutic exploratory (Phase II). Countries: Norway (authorised, recruitment pending).
Therapeutic area(s): Diseases [C] - Nervous System Diseases [C10]
Gender: Female, Male. Age: 18-64 years, 65+ years. Enrolment: 45.
Status: Authorised, recruitment pending. Decision date: 2026-06-02. Results received: No. Last updated: 2026-06-02.

Condition(s): Parkinson's Disease
Product: Placebo to match IMP/Mirivadelgat, Mirivadelgat

Primary endpoint: Incidence and severity of adverse events (AEs) and serious adverse events (SAEs); treatment adherence based on dosing compliance and study drug discontinuation rate., CSF-to-plasma concentration ratio of the Mirivadelgat metabolite AD-835 at Week 12, measured by LC-MS., Change from baseline to Week 12 in CSF total 4-HNE protein adduct levels, measured by validated ELISA assay.
Endpoint(s): Change from baseline to Week 12 in CSF levels of 4-HNE, measured by ELISA, or other relevant method., Change from baseline to Week 12 in CSF levels of TBARS (nmol malondialdehyde [MDA] equivalents per mL), measured using a validated thiobarbituric acid reactive substances (TBARS) spectrophotometric assay., Change from baseline to Week 12 in CSF levels of 4-HNE-α-synuclein using a custom sandwich ELISA assay., Change from baseline to Week 12 in the following brain bioenergetic indices: • Inorganic phosphate to ATP ratio (Pi/ATP), reflecting ATP turnover and energy consumption. • Phosphocreatine to inorganic phosphate (PCr/Pi) ratio, reflecting cellular energetic state and phosphorylation potential. • Phosphocreatine to ATP ratio (PCr/ATP), reflecting ATP resynthesis reserve and energetic state. measured by phosphorus magnetic resonance spectroscopy (31P-MRS) in the posterior brain.

Source: https://euclinicaltrials.eu/ctis-public/view/2025-523570-17-00